EU clinical trial 2023-505766-28-00: A Phase II/III, Extension Study of Orally Administered PHA-022121 for Acute Treatment of Angioedema Attacks in Patients with Hereditary Angioedema
Protocol code: PHA022121-C303
Sponsor: Pharvaris Netherlands B.V. (Pharmaceutical company). Phase: Phase II and Phase III (Integrated). Countries: Poland (ongoing, recruiting), Czechia (ongoing, recruiting), Hungary (ongoing, recruiting), Spain (ongoing, recruiting), Italy (ongoing, recruiting), Germany (ongoing, recruiting), Bulgaria (ongoing, recruiting), France (ongoing, recruiting), Sweden (ongoing, recruiting), Austria (ongoing, recruiting), Ireland (ended), Slovakia (ended), Romania (ended), Netherlands (ongoing, recruiting).
Therapeutic area(s): Diseases [C] - Immune System Diseases [C20]; Phenomena and Processes [G] - Immune system processes [G12]
Gender: Female, Male. Age: 0-17 years, 18-64 years, 65+ years. Enrolment: 82.
Start date (EU): 2022-10-10. Decision date: 2023-11-23. Results received: No. Last updated: 2026-06-01.
Decision dates by country: IE: 2025-01-10, SK: 2025-01-09, RO: 2025-01-13, FR: 2024-01-08, DE: 2023-12-08, IT: 2023-12-04, AT: 2024-12-27, PL: 2023-11-24, SE: 2024-12-04, NL: 2025-01-15, ES: 2023-11-23, BG: 2023-12-21, HU: 2023-11-23, CZ: 2023-11-23

Condition(s): Hereditary angioedema
Product: Test IMP (PHA-022121) without active substance, PHA-022121, ICATIBANT, Deucrictibant (PHA-022121)

Primary endpoint: 1. AEs, including treatment-emergent adverse events (TEAEs), treatment-related TEAEs, treatment-emergent serious adverse events (TESAEs), treatment-related TESAEs, and TEAEs leading to deucrictibant discontinuation, 4. Vital signs, 2. Clinical laboratory tests, 5. ECG, 3. Physical examination
Endpoint(s): 1. Part A, Efficacy: Time to onset of symptom relief, defined as Patient Global Impression of Change (PGI-C) rating of at least “a little better” for 2 consecutive timepoints within 12 hours post treatment., 2. Part A, Efficacy: Time to substantial symptom relief, defined as achieving PGI-C rating of at least “better” for 2 consecutive timepoints within 12 hours post-treatment, 3. Part A, Efficacy: Time to substantial symptom relief by Patient Global Impression of Severity (PGI-S), defined as achieving ≥1 point reduction in PGI-S from pre-treatment for 2 consecutive timepoints within 12 hours post-treatment., 4. Part A, Efficacy: Time to onset of symptom relief by VAS-3/ VAS-5 (defined as a reduction of ≥30% from pretreatment in VAS composite score, sustained for 2 consecutive timepoints), 5. Part A, Efficacy: Time to symptom relief by VAS (based on achieving ≥50% reduction from pretreatment in VAS composite score sustained for 2 consecutive timepoints)., 6. Part B, Efficacy: Time to onset of symptom relief, defined as Patient Global Impression of Change (PGI C) rating of at least “a little better” for 2 consecutive timepoints within 12 hours post treatment, 7. Part B, Efficacy: Time to substantial symptom relief, defined as achieving PGI-C rating of at least “better” for 2 consecutive timepoints within 12 hours post-treatment, 8. Part B, Efficacy: Time to substantial symptom relief by Patient Global Impression of Severity (PGI-S), defined as achieving ≥1 point reduction in PGI-S from pre-treatment for 2 consecutive timepoints within 12 hours post-treatment, 9. Part B, Efficacy: Time to onset of symptom relief by AMRA (defined as a reduction of ≥30% from pretreatment in AMRA composite score, sustained for 2 consecutive timepoints), 10. Part B, Efficacy: Time to symptom relief by AMRA (based on achieving ≥50% reduction from pretreatment in AMRA composite score sustained for 2 consecutive timepoints).

Source: https://euclinicaltrials.eu/ctis-public/view/2023-505766-28-00